EU clinical trial 2023-506745-33-00: A Study to Evaluate the Safety, Tolerability, Pharmacokinetics, and Preliminary Anti-Tumor Activity of Inavolisib in Combination with Paclitaxel in Patients with Locally Advanced or Metastatic Solid Tumors
Protocol code: CO42800
Sponsor: F. Hoffmann-La Roche AG (Pharmaceutical company). Phase: Human Pharmacology (Phase I)- Other. Countries: Denmark (ended), Spain (ended), France (ended).
Therapeutic area(s): Diseases [C] - Neoplasms [C04]
Gender: Female, Male. Age: 18-64 years, 65+ years. Enrolment: 30.
Status: Ended. Start date (EU): 2021-07-12. End date (EU): 2026-01-13. Decision date: 2024-06-12. Results received: No. Last updated: 2026-01-06.
Decision dates by country: DK: 2024-06-12, ES: 2024-06-17, FR: 2024-06-17

Condition(s): Locally Advanced or Metastatic Solid Tumors

Source: https://euclinicaltrials.eu/ctis-public/view/2023-506745-33-00